EU clinical trial 2024-510839-22-00: A Prospective Real-World Evidence Study Evaluating the Effects of Voltaren use on Mobility and Quality of Life
Protocol code: 300128
Sponsor: Haleon CH S.a.r.l. (Pharmaceutical company). Phase: Phase III and phase IV (Integrated). Countries: Poland (ended).
Therapeutic area(s): Diseases [C] - Musculoskeletal Diseases [C05]
Gender: Female, Male. Age: 18-64 years, 65+ years. Enrolment: 165.
Status: Ended. Start date (EU): 2024-07-18. End date (EU): 2024-10-29. End date: 2024-10-30. Decision date: 2024-07-01. Results received: Yes. Last updated: 2024-07-25.

Condition(s): Mild/non-serious osteoarthritis (OA) of the knee.
Product: Voltaren SPORT, 11,6 mg/g, żel, Voltaren MAX, 23,2 mg/g, żel

Primary endpoint: Change from baseline in the average minutes of Moderate and Vigorous Physical Activity (MVPA), at Week 1 (days 1-7), Week 2 (days 8-14), and Week 3 (days 15-21).
Endpoint(s): Change from baseline on Days 7, 14, and 21 in daily Average number of steps taken, Change from baseline on Days 7, 14, and 21 in daily Average number of stairs climbed/descended, Change from baseline on Days 7, 14, and 21 in ratio of sedentary/non-sedentary time, Change from baseline on Days 7, 14, and 21 in gait, assessed through speed and step irregularity, Change from baseline on Days 7, 14, and 21 in indices of morning stiffness (assessed through levels of mobility 30- and 60-mins post-wake)

Source: https://euclinicaltrials.eu/ctis-public/view/2024-510839-22-00